EU clinical trial 2023-507766-35-00: A Phase 2b, Extension Study to Determine the Long-term Safety of Vedolizumab IV in Pediatric Subjects With Ulcerative Colitis or Crohn’s Disease Long-term Safety With Vedolizumab IV in Pediatric Subjects With Ulcerative Colitis or Crohn’s Disease.
Protocol code: Vedolizumab-2005
Sponsor: Takeda Development Center Americas Inc. (Pharmaceutical company). Phase: Therapeutic exploratory (Phase II). Countries: Hungary (ended), Poland (ended).
Therapeutic area(s): Diseases [C] - Digestive System Diseases [C06]
Gender: Female, Male. Age: 0-17 years. Enrolment: 36.
Status: Ended. Start date (EU): 2018-01-09. End date (EU): 2025-07-09. End date: 2025-07-17. Decision date: 2024-03-27. Results received: Yes. Last updated: 2025-06-03.
Decision dates by country: PL: 2024-04-12, HU: 2024-03-27

Condition(s): Ulcerative Colitis or Crohn's Disease
Product: Entyvio 300 mg powder for concentrate for solution for infusion

Primary endpoint: The primary endpoint for this study is percentage of subjects with treatment-emergent adverse events (TEAEs).
Endpoint(s): Percentage of UC subjects who, at Week 32, achieve and maintain clinical response based on complete Mayo score, as defined by a continued reduction in complete Mayo score of ≥3 points from the baseline (at initiation of MLN0002-2003) and continued decrease in rectal bleeding subscore of ≥1 point from baseline, or absolute rectal bleeding subscore of ≤1 point at Week 32., Percentage of CD subjects who, at Week 32, achieve and maintain clinical response as defined by a 50% reduction in SES-CD score on endoscopy compared to the baselineendoscopy (at initiation of MLN0002-2003); and continued reduction in CDAI that is a ≥70 point decrease from the baseline CDAI score at the initiation of MLN0002-2003., Time to major IBD-related events (hospitalizations, surgeries, or procedures)., Changes from Baseline in IMPACT-III (where translations are available) total and subscale scores at Week 24 and every 24 weeks, thereafter., Height velocity at Week 48 and every 48 weeks, thereafter., Change from Baseline in height, weight, and body mass index (BMI) at Week 24 and every 24 weeks, thereafter., Percentage of subjects achieving Tanner stage V at or before age 16 years (females) or 17 years (males).

Source: https://euclinicaltrials.eu/ctis-public/view/2023-507766-35-00